EU clinical trial 2023-508301-25-00: BiCAR Therapy - A Phase II Trial Evaluating Glofitamab, a Bispecific CD3xCD20 Antibody for Relapse/Refractory Lymphomas after CAR T-cells therapy
Protocol code: BiCAR Therapy
Sponsor: LYSARC (Laboratory/Research/Testing facility). Phase: Therapeutic exploratory (Phase II). Countries: France (ended).
Therapeutic area(s): Diseases [C] - Hemic and Lymphatic Diseases [C15]
Gender: Female, Male. Age: 18-64 years, 65+ years. Enrolment: 78.
Status: Ended. Start date (EU): 2021-03-26. End date (EU): 2025-05-21. Decision date: 2023-11-23. Results received: Yes. Last updated: 2025-01-28.

Condition(s): Relapse/Refractory Lymphomas
Product: OBINUTUZUMAB, GLOFITAMAB

Primary endpoint: Overall Survival (OS).
Endpoint(s): tolerability of glofitamab, Overall Metabolic Response Rate (OMRR), Best metabolic response and overall best metabolic response rate, Progression Free Survival (PFS), Duration of Response (DoR),, HRQoL)

Source: https://euclinicaltrials.eu/ctis-public/view/2023-508301-25-00